EU clinical trial 2024-513570-22-00: Peroperative Administration of Tranexamic acid in Roux-en-Y and one-anastomosis gastric bypass to reduce haemorrhage (PATRY study): a randomized controlled trial
Protocol code: 2022-031
Sponsor: Sint Franciscus Vlietland Groep Stichting (Hospital/Clinic/Other health care facility). Phase: Therapeutic confirmatory (Phase III). Countries: Netherlands (ongoing, recruiting).
Therapeutic area(s): Diseases [C] - Nutritional and Metabolic Diseases [C18]
Gender: Female, Male. Age: 18-64 years. Enrolment: 1524.
Status: Ongoing, recruiting. Start date (EU): 2023-04-28. Decision date: 2024-05-23. Results received: No. Last updated: 2024-07-22.

Condition(s): Morbid obesity
Product: TRANEXAMIC ACID, SODIUM CHLORIDE

Primary endpoint: Postoperative intervention due to haemorrhage (defined as: administration of packed red blood cells, surgical-, radiological-, or endoscopic intervention).
Endpoint(s): Use hemostatic staple devices, amount of hemostatic staples, use of fibrin sealant, the amount of blood loss peroperatively, decrease in hemoglobin postoperatively, increase in heart rate postoperatively, hematemesis and/or melena, rates of postoperative hemorrhage (i.e. hemorrhage for which extra hemoglobin monitoring and/or administration of TXA and/or reinterventions), rates of VTE, other complications, hospitalization time, painscore, side effects of TXA, duration of primary surgery.

Source: https://euclinicaltrials.eu/ctis-public/view/2024-513570-22-00